EU clinical trial 2024-512903-38-00: An Open-Label, Multi-Centre, Phase Ib/II Study Evaluating the Safety and Efficacy of AUTO1, a CAR T Cell Treatment Targeting CD19, in Adult Patients with Relapsed or Refractory B Cell Acute Lymphoblastic Leukaemia.
Sponsor: Autolus Limited (Pharmaceutical company). Phase: Phase I and Phase II (Integrated)- Other. Countries: Spain (ongoing, recruitment ended).
Therapeutic area(s): Diseases [C] - Neoplasms [C04]
Gender: Female, Male. Age: 18-64 years, 65+ years. Enrolment: 17.
Status: Ongoing, recruitment ended. Start date (EU): 2021-12-01. Decision date: 2024-07-08. Results received: No. Last updated: 2026-07-10.

Condition(s): Relapsed or refractory B cell acute lymphoblastic leukaemia
Product: Fludarabina Teva 25 mg/ml concentrado para solución para perfusión o inyección EFG, AUTO1, Paracetamol MABO 500 mg comprimidos, Genoxal 200 mg polvo para solución inyectable y para perfusión

Primary endpoint: Frequency and severity of adverse events (AEs) and serious adverse events (SAEs) occurring after AUTO1 infusion., Cohort IIA: Overall complete remission rate (ORR) defined as proportion of patients achieving CR or CRi as assessed by an Independent Response Review Committee (IRRC). Cohort IIB: Proportion of patients achieving MRD-negative remission by central ClonoSEQ NGS testing (<10-4 leukaemic cells)
Endpoint(s): Complete Remission Rate (CRR). CRR within 3 months post AUTO1 infusion. Proportion of patients achieving MRD-negative remission by central ClonoSEQ NGS testing (<10-4 leukaemic cells), PCR and/or flow cytometry. Duration of remission (DOR). Duration of complete remission (DOCR). Event free survival (EFS). Progression free survival (PFS). Overall survival (OS). ORR [CR+CRi] as assessed by the Investigator., Frequency and severity of AEs and SAEs. Incidence and duration of severe hypogammaglobulinaemia., Proportion of enrolled patients for whom an AUTO1 product can be manufactured and administered., Detection of CAR T cells measured by PCR in the peripheral blood and BM following AUTO1 infusion., Depletion of circulating B cells assessed by flow cytometry in the peripheral blood.

Source: https://euclinicaltrials.eu/ctis-public/view/2024-512903-38-00